EU clinical trial 2024-513963-22-00: Cognitive function after liver transplantation comparing Tacrolimus formulations
Protocol code: CoFu-01
Sponsor: Universitaetsklinikum Schleswig-Holstein AöR (Hospital/Clinic/Other health care facility). Phase: Therapeutic use (Phase IV). Countries: Germany (ended).
Therapeutic area(s): Phenomena and Processes [G] - Immune system processes [G12]
Gender: Female, Male. Age: 18-64 years, 65+ years. Enrolment: 150.
Status: Ended. Start date (EU): 2020-12-09. End date (EU): 2026-01-29. Decision date: 2024-10-24. Results received: No. Last updated: 2025-05-19.

Condition(s): ICD 10: Z94.4 Liver transplant status
Product: Prograf 0,5 mg Hartkapseln, Prograf 1 mg Hartkapseln, Envarsus 0.75 mg prolonged-release tablets, Prograf 5 mg Hartkapseln, Envarsus 1 mg prolonged-release tablets, Envarsus 4 mg prolonged-release tablets

Primary endpoint: Change in subjective impression of QoL concerning attention/concentration and memory between Screening and visit 3 (6 months) using the FEDA (self-report questionnaire on attention and memory)
Endpoint(s): Cognitive function is assessed using (I) the Trail Making Test – TMT (time criterion), (II) Adaptive Digit Ordering Test – DOT-A (number of correctly sorted digits), (III) Digit Symbol Test – DST (number of correctly sorted items), (IV) Regensburg Stream of Speech Test – RWT (number of correct items), (V) Victoria Stroop Test – VST (time criterion), Quality of life (QoL) is measured using the SF36 (summary score). QoL will be performed during Screening, after 6 and after 12 months., Everyday executive function is measured by BAFQ (assessment by close relative/partner or care provider). BAFQ will be performed during Screening, after 6 and after 12 months., All (serious) adverse events including clinically significant laboratory parameters and relevant liver and kidney functioning parameters are documented at each visit after baseline.

Source: https://euclinicaltrials.eu/ctis-public/view/2024-513963-22-00